EU clinical trial 2022-501993-21-00: PERELI - A phase 2, open label study of PEmigatinib and REtifanlimab in advanced dedifferentiated Liposarcoma
Protocol code: PERELI
Sponsor: Region Skane (Hospital/Clinic/Other health care facility). Phase: Therapeutic exploratory (Phase II). Countries: Sweden (ongoing, recruiting), Norway (ongoing, recruiting), Denmark (authorised, recruitment pending).
Therapeutic area(s): Diseases [C] - Neoplasms [C04]
Gender: Female, Male. Age: 18-64 years, 65+ years. Enrolment: 33.
Start date (EU): 2024-06-20. Decision date: 2023-10-02. Results received: No. Last updated: 2026-06-11.
Decision dates by country: NO: 2023-10-04, SE: 2023-10-03, DK: 2023-10-02

Condition(s): Dedifferentiated Liposarcoma
Product: Retifanlimab (INCMGA00012), Pemazyre 4.5 mg tablets

Primary endpoint: Progression-fee survival (PFS) at 24 weeks. PFS is defined as the time from the first dosing date to the date of the first objectively documented disease progression or death du to any cause, whichever occurs first. Disease progression based on tumor assessment (RECIST version 1.1 criteria).
Endpoint(s): Objective response rate (ORR) defined as the percentage of patients achieving a confirmed complete or partial response, as defined by RECIST v. 1.1., Overall survival (OS) is calculated as the time from date of start of the treatment to the date of death due to any cause., Percentage of patients by Best Overall Response (BOR) according to RECIST v1.1. BOR is the best response (CR, PR, SD or PD) recorded from the start of the study treatment until disease progression., Time to response (TTR), calculated as the time from the date of start of treatment until the first documented CR or PR., Duration of response (DOR) is calculated as the time from the date of the first documented CR or PR to the first documented progression or death due to underlying cancer., Incidence and severity of adverse events (AEs) and serious adverse events (SAEs) include all changes in laboratory values, vital signs, and assessment of physical, dermatological examinations graded according to the National Cancer Institute (NCI) Common Terminology Criteria for Adverse Events (CTCAE) v5., Changes in patient performance status (PS) from baseline in the Eastern Cooperative Oncology Group (ECOG) PS at 24 weeks., Changes in Quality of life (QoL) from baseline assessed by EORTC QLQ-C30 questionnaire.

Source: https://euclinicaltrials.eu/ctis-public/view/2022-501993-21-00